EU clinical trial 2023-509555-13-00: Pharmacokinetic/pharmacodynamic evaluation of ublituximab in patients with autoimmune diseases
Protocol code: TG1101-RMS-SC101
Sponsor: Tg Therapeutics Inc. (Pharmaceutical company). Phase: Human Pharmacology (Phase I)- First administration to humans. Countries: Poland (ongoing, recruitment ended).
Therapeutic area(s): Diseases [C] - Nervous System Diseases [C10]
Gender: Female, Male. Age: 18-64 years, 65+ years. Enrolment: 164.
Status: Ongoing, recruitment ended. Start date (EU): 2024-05-15. Decision date: 2024-05-06. Results received: No. Last updated: 2026-06-29.

Condition(s): Myasthenia Gravis, Relapsing multiple sclerosis
Product: DIPHENHYDRAMINE, DEXAMETHASONE, METHYLPREDNISOLONE, Ublituximab, ublituximab, ublituximab, PARACETAMOL, CETIRIZINE

Primary endpoint: Pharmacokinetic assessment of intravenous and subcutaneous administration of ublituximab, B-cell count following intravenous and subcutaneous administration of ublituximab

Source: https://euclinicaltrials.eu/ctis-public/view/2023-509555-13-00